EU clinical trial 2023-506152-24-00: Goal-directed Fluid Therapy during deep inferior epigastric perforator (DIEP) free flap breast reconstruction – a randomized controlled trial
Sponsor: Az Maria Middelares Gent (Hospital/Clinic/Other health care facility). Phase: Therapeutic use (Phase IV). Countries: Belgium (ongoing, recruiting).
Therapeutic area(s): Analytical, Diagnostic and Therapeutic Techniques and Equipment [E] - Anesthesia and Analgesia [E03]
Gender: Female. Age: 18-64 years, 65+ years. Enrolment: 82.
Status: Ongoing, recruiting. Start date (EU): 2023-11-28. Decision date: 2023-09-22. Results received: No. Last updated: 2024-01-04.

Condition(s): Arterial hypotension during deep inferior epigastric perforator (DIEP) free flap breast reconstruction
Product: Plasma-Lyte® 148 (pH 7.4) solution for infusion, NORADRENALINE (NOREPINEPHRINE) 1 mg / ml Concentrate for solution for infusion

Primary endpoint: Total intraoperative fluid volume (from anaesthesia induction until completed skin closure)
Endpoint(s): cumulative perioperative fluid volume (intraoperative fluid volume + fluid administered in the intensive care unit (ICU) or post-anaesthesia care unit (PACU)), cumulative intraoperative norepinephrine dose (intraoperative and postoperative norepinephrine dose), peri- and postoperative blood lactate levels (hourly measurement during surgery, every four hours in the ICU until discharge), percentage of time SBP was above 100mmHg, postoperative free flap perfusion monitored by NIRS during ICU/ PACU stay, surgical complications (e.g. total or partial flap loss, venous flap congestion, hematoma) assessed at ICU/ PACU discharge and at hospital discharge, ICU/PACU length of stay (LOS) (hours)

Source: https://euclinicaltrials.eu/ctis-public/view/2023-506152-24-00